EU clinical trial 2024-511257-22-00: A Phase 3 Study to Evaluate the Safety and Pharmacokinetics of Berotralstat Prophylaxis in Children with Hereditary Angioedema (HAE) Who Are 2 To < 12 Years of Age.
Protocol code: BCX7353-304
Sponsor: Biocryst Pharmaceuticals Inc. (Pharmaceutical company). Phase: Therapeutic confirmatory (Phase III). Countries: Spain (ended), Austria (ended), Germany (ongoing, recruitment ended), Poland (ongoing, recruitment ended), Italy (ended), France (ongoing, recruitment ended).
Therapeutic area(s): Diseases [C] - Congenital, Hereditary, and Neonatal Diseases and Abnormalities [C16]
Gender: Female, Male. Age: 0-17 years. Enrolment: 18.
Start date (EU): 2022-10-13. Decision date: 2024-09-20. Results received: No. Last updated: 2026-08-05.
Decision dates by country: AT: 2024-09-29, ES: 2024-09-20, IT: 2024-09-30, PL: 2024-09-25, DE: 2024-09-25, FR: 2024-10-08

Condition(s): Hereditary Angioedema (HAE)
Product: Berotralstat, Berotralstat, Orladeyo 150 mg hard capsules, Berotralstat, Berotralstat

Primary endpoint: PK : The primary endpoint is the characterization of the PK profile of berotralstat in subjects aged 2 to < 12 years.
Endpoint(s): Safety : The frequency and severity of adverse events (AEs) and serious adverse events (SAEs), laboratory analyses (clinical chemistry, hematology, coagulation), height, weight, vital signs, electrocardiograms (ECGs), and physical examination findings, Effectiveness: The frequency of attacks, duration of symptoms, anatomical location of attack, on-demand treatment, number of days with angioedema symptoms, assessment of attack severity, discontinuations due to lack of efficacy, and number of hospitalizations and clinic visits from Week 1 through Weeks 12 and 48

Source: https://euclinicaltrials.eu/ctis-public/view/2024-511257-22-00